EU clinical trial 2023-504615-33-00: Focus Green: Fluorescence-guided resection Of Colorectal liver metastases Using SGM-101 and Indocyanine GREEN
Sponsor: Leiden University Medical Center (Hospital/Clinic/Other health care facility). Phase: Therapeutic exploratory (Phase II). Countries: Netherlands (ended).
Therapeutic area(s): Analytical, Diagnostic and Therapeutic Techniques and Equipment [E] - Diagnosis [E01]; Diseases [C] - Neoplasms [C04]
Gender: Female, Male. Age: 18-64 years, 65+ years. Enrolment: 10.
Status: Ended. Start date (EU): 2023-12-12. End date (EU): 2025-05-14. Decision date: 2023-08-14. Results received: No. Last updated: 2023-11-09.

Condition(s): colorectal livermetastases
Product: SGM-101

Primary endpoint: A positive score on practical workability measured with survey A ‘practical workability during surgery’ (see section 8.1.4), defined as an average score of at least neutral., A positive score on the patient’s experience measured with survey B ‘patient experience’ (see section 8.1.4), defined as an average score of at least neutral., SGM-101: at least 80% sensitivity, measured as follows: - Capsular lesions, that are visible in white light are only counted positive if TBR ≥ 1.5 in vivo. - Subcapsular lesions that are not visible in white light will be counted as positive if: A: TBR ≥ 1.5 in vivo, OR B: TBR ≥ 1.5 ex vivo on whole specimen OR C: TBR ≥ 1.5 ex vivo on bread loafs, No cross-interference of fluorescent signal of both dyes within the two different excitation and emission channels. Cross-Interference is deemed insignificant if at macroscopic bread loaf imaging with the Quest spectrum System: A: At the 800nm channel the rim signal (ICG, 800nm) to tumour (possibly due to SGM-101, 700nm) ratio (STR) ≥ 1.5 in ICG positive tumours. B: At the 700nm channel the tumour (SGM, 700nm) to rim signal (ICG, 800nm) ratio (TRR) ≥ 1.5 in SGM-101 positive tumours
Endpoint(s): The accuracy of ICG, SGM-101 or both to demonstrate an irradical resection. The accuracy comprises of the rate of true positives, true negatives, false positives and false negative with accompanied sensitivity, specificity, positive predictive value and negative predictive value, Concordance rate of ICG, SGM-101, ICG and SGM-101 combined (both fluorescent) or ICG and SGM-101 combined (for which only one is fluorescent), to histopathological result (lesion benign vs malignant). The concordance rate comprises of the rate of true positives, true negatives, false positives and false negative with accompanied sensitivity, specificity, positive predictive value and negative predictive value., For every lesion a TBR (SGM-101) /SBR (ICG) will be calculated in vivo (Quest open camera), ex vivo whole specimen (Quest open camera, Pearl system) and ex vivo bread loafs (Quest open camera, Pearl system)., Modification of operative plan due to imaging (e.g. extension of resection margins, additional resection, preservation of tissue) and the correlation to histopathology., Survey C ‘surgeon’s satisfaction and judged potency’ questionnaire (see section 8.1.4) will be handed to all the surgeons at the end of the trial that have at minimum operated 3 times within this trial. Outcomes will be analysed., To assess the correlation between lesion CEA expression, performed using immunohistochemistry staining, to bread loaf TBR (SGM-101) measured with the Pearl system., Effect of tumour depth on fluorescent status of ICG/SGM-101, To evaluate the feasibility of minimally invasive diagnostic approach for the early detection of colorectal cancer through circulating tumor cells and extracellular vesicles., To evaluate the feasibility of using CTCs and EVs in the blood of CRC patients as biomarkers for early detection of recurrence/metastasis., To evaluate the feasibility of using CTCs and EVs from peripheral blood for disease monitoring and early cancer detection.

Source: https://euclinicaltrials.eu/ctis-public/view/2023-504615-33-00